EU clinical trial 2024-520067-13-00: EaRly impAct theraPy with ceftazidime-avibactam via rapID diagnostics versus standard of care antibiotics and diagnostics in patients with bloodstream infection, hospital-acquired pneumonia or ventilator-associated pneumonia due to Pseudomonas aeruginosa or carbapenemase producing Enterobacterales ("RAPID")
Protocol code: 22-002
Sponsor: National University Of Singapore (Educational Institution). Phase: Therapeutic use (Phase IV). Countries: Italy (authorised, recruitment pending).
Therapeutic area(s): Diseases [C] - Bacterial Infections and Mycoses [C01]
Gender: Female, Male. Age: 18-64 years, 65+ years. Enrolment: 80.
Status: Authorised, recruitment pending. Decision date: 2026-04-29. Results received: No. Last updated: 2026-04-29.

Condition(s): Bloodstream Infection, Ventilator Associated Pneumonia and Hospital-Acquired Pneumonia
Product: Zavicefta 2 g/0.5 g powder for concentrate for solution for infusion

Primary endpoint: Composite endpoint of all-cause mortality and/or no improvement in Sequential Organ Failure Assessment (SOFA) score at Day 14 post index culture
Endpoint(s): Clinical response at Day 7 and Day 14 post index culture, as defined by a set of clinical criteria signifying cardiopulmonary stability for 48 hours, All-cause mortality at Day 14, Day 28, and Day 60 post index culture, Days alive and out of hospital in the 60 days from date of index culture, Length of stay in ICU in the 60 days from date of index culture, Length of stay in hospital in the 60 days from date of index culture, Type of accommodation on discharge from hospital, Duration of mechanical ventilation in the 60 days from date of index culture, Persistence of bacteremia at Day 4 from date of index blood culture, Persistence of microbiologic growth at Day 7 from date of index respiratory culture, of at least one organism growing from index respiratory culture, Development of resistance to meropenem or ceftazidime-avibactam in any bacteria grown from clinically-indicated cultures collected in the 28 days from date of index culture, Development of acute kidney injury (modified KDIGO definitions) in the 28 days from date of index culture<, Development of Clostridioides difficile diarrhea in the 28 days from date of index culture collection, Time from index culture sample received by the laboratory to antibiotic therapy active in vitro (in hours)<, Percentage of patients undergoing modification of antibiotic therapy in the 7 days after microbiology diagnostics for the index culture, Number of days on antibiotics in the 28 days from date of index culture collection (total, and by antibiotic type)<, Time from index culture sample received by the laboratory to detection of carbapenem resistance (in hours, Time from index culture sample received by the laboratory to detection of resistance to ceftriaxone/cefotaxime (in hours)<, Time from index culture sample received by the laboratory to detection of Acinetobacter baumannii calcoaceitcus complex or Stenotrophomonas maltophilia (in hours, Functional outcome at Day 28 and Day 60 from collection of index culture, Composite outcome measure defined by Desirability of Outcome Ranking (DOOR) at Day 28 from index culture sample, Cost-effectiveness of the Intervention, compared to Control, from the health system perspective, Up to 60 days from date of index culture

Source: https://euclinicaltrials.eu/ctis-public/view/2024-520067-13-00